EU clinical trial 2023-507493-41-00: A single-arm, prospective, multicentre, open-label study to evaluate ofatumumab treatment effectiveness and patient-reported outcomes (PRO) in patients with relapsing multiple sclerosis (RMS) transitioning from fumarate-based RMS approved therapies or fingolimod.
Protocol code: COMB157G23101
Sponsor: Novartis Pharma AG (Pharmaceutical company). Phase: Therapeutic confirmatory (Phase III). Countries: Poland (ended), Bulgaria (ended), Portugal (ended), Slovakia (ended), Germany (ended), Slovenia (ended), Spain (ended), Latvia (ended).
Therapeutic area(s): Diseases [C] - Nervous System Diseases [C10]
Gender: Female, Male. Age: 18-64 years. Enrolment: 293.
Status: Ended. Start date (EU): 2020-08-04. End date (EU): 2024-09-27. End date: 2025-03-11. Decision date: 2024-07-08. Results received: Yes. Last updated: 2024-07-24.
Decision dates by country: BG: 2024-07-12, DE: 2024-07-09, LV: 2024-07-08, PT: 2024-07-10, SI: 2024-07-11, ES: 2024-07-23, PL: 2024-07-24, SK: 2024-07-08

Condition(s): relapsing multiple sclerosis (RMS)
Product: Kesimpta 20 mg solution for injection in pre-filled pen, Kesimpta 20 mg solution for injection in pre-filled pen

Primary endpoint: Annual relapse rate (ARR, based on confirmed relapses) measured over the 96 weeks
Endpoint(s): Proportion of subjects with adverse events, including injection related reactions, Proportion of patients with laboratory or vital signs results meeting abnormal criteria, The proportion of subjects discontinuing treatment due to insufficient effectiveness (lack of efficacy) or tolerability/safety reasons

Source: https://euclinicaltrials.eu/ctis-public/view/2023-507493-41-00